EU clinical trial 2024-511989-36-00: INTER-EWING-1: International Clinical Research Programme to Improve Outcomes in Newly Diagnosed Ewing Sarcoma – Trial 1
Protocol code: RG_21-151
Sponsor: The University Of Birmingham (Educational Institution). Phase: Therapeutic confirmatory (Phase III). Countries: Denmark (ongoing, recruiting), Spain (ongoing, recruiting), Netherlands (ongoing, recruiting), Norway (authorised, recruitment pending), France (authorised, recruitment pending).
Therapeutic area(s): Diseases [C] - Neoplasms [C04]
Gender: Female, Male. Age: 0-17 years, 18-64 years, 65+ years. Enrolment: 498.
Start date (EU): 2025-09-24. Decision date: 2025-07-14. Results received: No. Last updated: 2026-07-24.
Decision dates by country: DK: 2025-07-14, NL: 2025-07-18, FR: 2025-07-21, ES: 2025-07-17, NO: 2025-07-17

Condition(s): Ewing Sarcoma
Product: VINORELBINE, VINORELBINE, VINORELBINE, CYCLOPHOSPHAMIDE, VINORELBINE, CYCLOPHOSPHAMIDE

Primary endpoint: The primary end point for all randomisations is Event-free survival, defined as the time from randomisation until first failure event
Endpoint(s): Randomisation A: Induction chemotherapy Overall Survival, Toxicity, Cancer Quality of Life Measures, Histological response (if surgery is performed), Randomisations B1 & B2: Radiotherapy Local Failure-Free Survival Time, Overall Survival, Toxicity, Achievement of local control, Acute post-radiotherapy toxicity, Late toxicity, Cancer Quality of Life Measures, Randomisation C: Maintenance therapy Overall Survival, Toxicity, Cancer Quality of Life Measures

Source: https://euclinicaltrials.eu/ctis-public/view/2024-511989-36-00